EU clinical trial 2022-501315-13-00: LYSARI – LYmphocyte-Sparing And Radio-Immunotherapy in Head and neck carcinoma - A multicenter, randomised 2*2 factorial design comparing standard to reduced-target volume radiotherapy with or without all-trans retinoic acid (ATRA) in patients with lateralised oropharyngeal, laryngeal and hypopharyngeal squamous cell carcinoma.
Protocol code: LYSARI/ET22-156
Sponsor: Centre Leon Berard (Hospital/Clinic/Other health care facility). Phase: Therapeutic confirmatory (Phase III). Countries: Belgium (authorised, recruitment pending), France (ongoing, recruiting), Italy (authorised, recruitment pending).
Therapeutic area(s): Diseases [C] - Pathological Conditions, Signs and Symptoms [C23]; Diseases [C] - Neoplasms [C04]
Gender: Female, Male. Age: 18-64 years, 65+ years. Enrolment: 460.
Start date (EU): 2025-03-06. Decision date: 2024-10-21. Results received: No. Last updated: 2026-08-07.
Decision dates by country: BE: 2024-10-23, FR: 2024-10-21, IT: 2024-10-25

Condition(s): Patients with lateralised oropharyngeal, laryngeal and hypopharyngeal squamous cell carcinoma
Product: CETUXIMAB, TRETINOIN, CISPLATIN

Primary endpoint: Event Free Survival (EFS)
Endpoint(s): Local relapse free survival; Regional relapse free survival; Metastases free survival; Rate of pathologically positive lymph nodes at neck node dissection performed at 4 months after the completion of (chemo)-radiotherapy for those patients benefiting from a neck node dissection; EFS considering that pathologically positive lymph nodes at neck node dissection performed at 4 months after the completion of (chemo)-radiotherapy is not an event and Overall survival, Incidence of AEs using NCI CTCAE 5.0, Changes from baseline in i) Global Health Scale/Quality of Life and Fatigue using European Organisation for Research and Treatment of Cancer (EORTC) QLQ-C30 questionnaire and EQ5D and ii) swallowing and Pain using EORTC QLQ-H&N43 questionnaire, * Cost-effectiveness (based on efficacy) * Analysis and Cost-Utility (based on QALY) Analysis, Exploratory objetives: Immunomonitoring on isolated PBMCs

Source: https://euclinicaltrials.eu/ctis-public/view/2022-501315-13-00